EU clinical trial 2024-515349-41-00: SAFIR 03 - LibHERty: A ctDNA screening program in patients with HR+, HER2 low metastatic breast cancer for detection of high-risk relapse patients on any CDK4/6 inhibitor followed by a single arm phase II trial of trastuzumab-deruxtecan in patients with persistent ctDNA after 1 month of treatment with endocrine therapy combined with CDK4/6 inhibitor
Protocol code: UC-GMP-2402
Sponsor: Unicancer (Hospital/Clinic/Other health care facility). Phase: Therapeutic exploratory (Phase II). Countries: France (ongoing, recruiting).
Therapeutic area(s): Diseases [C] - Neoplasms [C04]
Gender: Female, Male. Age: 18-64 years, 65+ years. Enrolment: 600.
Status: Ongoing, recruiting. Start date (EU): 2025-07-29. Decision date: 2025-05-13. Results received: No. Last updated: 2026-03-11.

Condition(s): Metastatic Breast Cancer HR+, HER2-
Product: DS-8201a

Primary endpoint: Progression-free survival is defined as the time from the first T-DXd administration to the first documented disease progression or death from any cause, whichever occurs first. The tumour assessments are conducted by investigators according to RECIST 1.1 every 6 weeks during the first 12 months of treatment phase, and every 9 weeks thereafter.
Endpoint(s): Overall survival (OS): defined as the time from the first T-DXd administration to death due to any cause. Patients still alive at the cut-off time (including lost to follow-up) will be censored at the last known alive date., Objective response Rate (ORR): ORR will be assessed by the investigators using RECIST v1.1 and is defined as the proportion of patients who achieved a confirmed complete response (CR) or partial response (PR) up to 6 months after the first administration of treatment., Duration of response (DoR) is defined as the time interval from the date of first documentation of confirmed CR or PR to the date of first documented disease progression or death, from any cause whichever occurs first. Patients without progression at the cut-off date will be censored at the last assessment date, Clinical Benefit Rate (CBR): CBR will be assessed by the investigators using RECIST v1.1 and is defined as the proportion of patients with at least a confirmed complete response (CR) or partial response (PR) up to 6 months after the first administration of treatment or a stable disease for 6 months or more after the first administration of treatment., Time to Response (TTR): TTR is defined, for patients with an objective response according to RECIST v1.1, as the time from the first T-DXd administration to the first documentation of objective response which is subsequently confirmed., The assessment of the incidences of adverse events, graded by NCI CTC-AE v5.

Source: https://euclinicaltrials.eu/ctis-public/view/2024-515349-41-00